EU clinical trial 2025-521040-37-00: Diagnostic HER2DX-guided trEatment For patIeNts wIth early-sTage HER2-positIVE breast cancer
Protocol code: HCB-ONC002
Sponsor: Fundacio De Recerca Clinic Barcelona-Institut D’Investigacions Biomediques August Pi I Sunyer (Laboratory/Research/Testing facility). Phase: Therapeutic confirmatory (Phase III). Countries: Germany (authorised, recruiting), Ireland (ongoing, recruiting), France (ongoing, recruiting), Spain (authorised, recruitment pending).
Therapeutic area(s): Diseases [C] - Neoplasms [C04]
Gender: Female, Male. Age: 18-64 years, 65+ years. Enrolment: 224.
Start date (EU): 2025-11-26. Decision date: 2025-08-28. Results received: No. Last updated: 2026-04-08.
Decision dates by country: FR: 2025-09-01, DE: 2025-08-29, IE: 2025-08-29, ES: 2025-08-28

Condition(s): HER2-positive early breast cancer
Product: CYCLOPHOSPHAMIDE, EPIRUBICIN, TRASTUZUMAB EMTANSINE, PACLITAXEL, DOXORUBICIN, DOCETAXEL, PACLITAXEL ALBUMIN-BOUND, TRASTUZUMAB, CARBOPLATIN, Phesgo 1200 mg/600 mg solution for injection, Phesgo 600 mg/600 mg solution for injection, TRASTUZUMAB, PERTUZUMAB

Primary endpoint: The study will evaluate superiority in quality of life using i) the global health status (GHS) scale from the EORTC QLQ-C30 questionnaire version 3.0 and ii) the score from the FACIT Fatigue Scale (Version 4). Dual primary quality of life endpoints: • The GHS scale is based on two 7-point questions (from very poor to excellent, items 29-30 from EORTC QLQ-C30 questionnaire). • The score from the FACIT Fatigue Scale is based on 13-item questionnaire (from 0 to 4). The total score ranges from 0 t
Endpoint(s): Change from baseline in all other functional and symptom scales from the EORTC QLQ-C30 questionnaire. Change from baseline to surgery in the score of the EuroQol-5D., The residual cancer burden (RCB), when available. RCB is defined as classes 0, 1, 2 and 3, according to the MD Anderson Cancer Center recommendations by local evaluation. The invasive disease-free survival (iDFS), distant metastasis free survival (DMFS), recurrence-free interval (RFI) and event-free survival (EFS) of patients., PCR rates according to the predefined HER2DX pCR score i) as a continuous variable and ii) as group categories. The RCB (when available) according to HER2DX pCR score as a continuous variable and as group categories. RCB is defined as classes 0, 1, 2 and 3, according to the MD Anderson Cancer Center recommendations by local evaluation in both treatment arms according to HER2DX pCR score in continuous variable and risk group.The iDFS, DMFS, RFI and EFS of patients according to HER2DX risk scor, Incidence, duration, and severity of AEs assessed by the NCI Common Terminology for Classification of AEs (CTCAE) version 5, including dose reductions, delays, and treatment discontinuations. Percentage of amenorrhea one year after finishing the neo/adjuvant treatment in premenopausal women without LHRH treatment., The following dimensions of experience will be evaluated: Team accessibility, Communication, Information from care providers, Care continuum coordination, respect and courtesy, secondary effects management, shared decision making, language barriers and overall care perception, using the CAHPS cancer care survey (AHQR)., Health economic evaluation to compare the cost-effectiveness in patients with and without HER2DX test information, not only direct cost for hospitals/public health system, but also indirect cost for public system., The Work Productivity and Activity Impairment Questionnaire (WPAI-GH).

Source: https://euclinicaltrials.eu/ctis-public/view/2025-521040-37-00